EU clinical trial 2023-508810-41-00: A Single Ascending Dose, Single-Centre Study, to Assess Pharmacokinetics, Safety and Tolerability of a Single Intramuscular Dose of Bedaquiline Long-Acting Injection Formulation in Healthy Participants
Protocol code: TMC207TBC1006
Sponsor: Janssen Cilag International (Pharmaceutical company). Phase: Human Pharmacology (Phase I)- Other. Countries: Austria (ended).
Therapeutic area(s): Diseases [C] - Bacterial Infections and Mycoses [C01]
Gender: Female, Male. Age: 18-64 years. Enrolment: 32.
Status: Ended. Start date (EU): 2024-07-01. End date (EU): 2026-04-27. Decision date: 2024-06-24. Results received: No. Last updated: 2025-07-07.

Condition(s): Tuberculosis

Source: https://euclinicaltrials.eu/ctis-public/view/2023-508810-41-00